EU clinical trial 2023-507490-18-00: Enhanced recovery and Abbreviated Length of Anticoagulation for Thromboprophylaxis after primary Hip Arthroplasty – the ENABLE-Hip Trial
Protocol code: 23-01496
Sponsor: Universitaetsmedizin Der Johannes Gutenberg-Universitaet Mainz Koerperschaft Des Offentlichen Rechts (Hospital/Clinic/Other health care facility). Phase: Therapeutic confirmatory (Phase III). Countries: Germany (ongoing, recruiting), Austria (ongoing, recruiting).
Therapeutic area(s): Diseases [C] - Musculoskeletal Diseases [C05]
Gender: Female, Male. Age: 18-64 years, 65+ years. Enrolment: 5000.
Status: Ongoing, recruiting. Start date (EU): 2024-11-26. Decision date: 2024-07-31. Results received: No. Last updated: 2026-07-27.
Decision dates by country: DE: 2024-07-31, AT: 2024-08-12

Condition(s): Patients undergoing elective unilateral primary hip arthroplasty, who fulfil the criteria for a fast-track protocol including early mobilization and discharge from the hospital after surgery.
Product: Rivaroxaban, Placebo hard capsules were manufactured from P-tablets (P-Tabletten weiß 7 mm Lichtenstein®, Zulassungs-Nr. 6866372.00.00). For further information see SmPC

Primary endpoint: Participation in another interventional clinical trial at inclusion or within the last 30 days prior to inclusion, except during the observational follow-up period of that other trial
Endpoint(s): Death from any cause, isolated symptomatic distal DVT, myocardial infarction or stroke, need for readmission to the hospital and length of hospital stay;, serious adverse events (SAEs), patient mobility, changes in patientreported hip joint-specific disability following surgery, generic quality of life, postoperative healthcare resource utilization within the first 35 days after surgery, Overt major or clinically relevant non-major bleeding

Source: https://euclinicaltrials.eu/ctis-public/view/2023-507490-18-00